EU clinical trial 2022-501332-42-00: A Phase 3, Multicenter, Double Blind, Active-Controlled Study to Evaluate the Efficacy, Safety, Tolerability, Pharmacokinetics, and Pharmacodynamics of Oral Ozanimod Compared to Oral Fingolimod in Children and Adolescents with Relapsing Remitting Multiple Sclerosis
Protocol code: IM047-050
Sponsor: Bristol-Myers Squibb Services Unlimited Company (Pharmaceutical company). Phase: Therapeutic confirmatory (Phase III). Countries: Spain (ongoing, recruiting), Poland (ended), Portugal (ongoing, recruiting), Italy (ongoing, recruiting), Romania (authorised, recruiting).
Therapeutic area(s): Diseases [C] - Nervous System Diseases [C10]
Gender: Female, Male. Age: 0-17 years. Enrolment: 38.
Start date (EU): 2025-02-26. Decision date: 2024-09-11. Results received: No. Last updated: 2026-08-06.
Decision dates by country: PL: 2024-09-16, IT: 2024-09-13, RO: 2024-09-19, PT: 2024-09-12, ES: 2024-09-11

Condition(s): Relapsing Remitting Multiple Sclerosis
Product: Ozanimod HCl, Ozanimod HCl, Fingolimod 0.25 mg capsule, Fingolimod 0.5 mg capsule, Ozanimod HCl, Ozanimod HCl, FINGOLIMOD, FINGOLIMOD, Ozanimod HCl 0.23 mg , Ozanimod HCl 1 mg , Ozanimod HCl 0.0575 mg , Ozanimod HCl 0.25 mg

Primary endpoint: Core phase: To assess rate of Multiple Sclerosis (MS) relapse over 2 years
Endpoint(s): Core and Extension Phase: proportion of the participants who have worsening or improving RRMS, Core and Extension Phase: occurrence of adverse events (type, severity and relationship to the study drug), Core and Extension Phase: early study discontinuation, Core and Extension Phase: measurements of the amount of ozanimod in a participant’s body

Source: https://euclinicaltrials.eu/ctis-public/view/2022-501332-42-00